EU clinical trial 2024-515339-30-00: Intensive Intraperitoneal Therapy in Advanced Ovarian Cancer
Protocol code: PROICM 2019-08 INT
Sponsor: Institut Regional Du Cancer De Montpellier (Hospital/Clinic/Other health care facility). Phase: Therapeutic exploratory (Phase II). Countries: France (authorised, recruitment pending).
Therapeutic area(s): Diseases [C] - Neoplasms [C04]
Gender: Female. Age: 18-64 years, 65+ years. Enrolment: 55.
Status: Authorised, recruitment pending. Decision date: 2024-09-05. Results received: No. Last updated: 2024-09-05.

Condition(s): Ovarian Cancer

Source: https://euclinicaltrials.eu/ctis-public/view/2024-515339-30-00